EU clinical trial 2025-524484-20-00: Rapid Oral Switch in Infectious Endocarditis, the ROSIE trial
Protocol code: S70926
Sponsor: UZ Leuven (Hospital/Clinic/Other health care facility). Phase: Therapeutic use (Phase IV). Countries: Belgium (ongoing, recruiting).
Therapeutic area(s): Diseases [C] - Bacterial Infections and Mycoses [C01]; Diseases [C] - Cardiovascular Diseases [C14]; Analytical, Diagnostic and Therapeutic Techniques and Equipment [E] - Therapeutics [E02]
Gender: Female, Male. Age: 18-64 years, 65+ years. Enrolment: 152.
Status: Ongoing, recruiting. Start date (EU): 2026-03-30. Decision date: 2026-02-06. Results received: No. Last updated: 2026-02-06.

Condition(s): Infective Endocarditis
Product: Gentamycine B. Braun 1 mg/ml solution pour perfusion, AmoclaneEG 875 mg/125 mg Filmtabletten, Amoxicillin AB 1000 mg dispergeerbare tabletten, Cefazoline Sandoz 1 g poeder voor oplossing voor injectie, Floxapen, poeder voor oplossing voor injectie 1 g, EUSAPRIM Forte 160 mg/800 mg tabletten, Avelox 400 mg Filmtabletten, Delamoxyle 1 g, poudre pour solution injectable/pour perfusion, Ceftriaxone Fresenius Kabi 1 g poeder voor oplossing voor injectie of infusie, Clindamycin Sandoz 300 mg harde capsules, Rifadine 300 mg capsules, hard, Penicilline 1.000.000 IE, poeder voor oplossing voor injectie, Levofloxacine EG 500 mg comprimés pelliculés

Primary endpoint: Primary: composite clinical success at 6 months, defined as the absence of all-cause mortality, unplanned cardiac surgery, embolic events, recurrent bacteremia
Endpoint(s): Patient-reported satisfaction at completion of oral treatment., Complications (including antibiotic-related adverse events, treatment interruption/modification, non-adherence), during the entire treatment course., PK/PD target attainment of oral antibiotics, assessed per agent, based on predefined PK/PD thresholds at two time point during treatment., Length and cost of hospital stay, calculated from admission to discharge., Total duration of antibiotic therapy, calculated from treatment initiation until the final antibiotic dose administered for the same endocarditis episode.

Source: https://euclinicaltrials.eu/ctis-public/view/2025-524484-20-00